EU clinical trial 2024-513878-21-02: AMEND - Add-on MEmaNtine to Dopamine modulation to improve negative symptoms at first psychosis
Sponsor: Region Hovedstadens Psykiatriske (Hospital/Clinic/Other health care facility). Phase: Human Pharmacology (Phase I)- Other. Countries: Denmark (ended).
Therapeutic area(s): Psychiatry and Psychology [F] - Mental Disorders [F03]
Gender: Female, Male. Age: 18-64 years. Enrolment: 46.
Status: Ended. Start date (EU): 2024-11-11. End date (EU): 2025-04-08. Decision date: 2024-11-11. Results received: Yes. Last updated: 2024-11-11.

Condition(s): First episode psychosis; ICD-10: F20.x; F22.x; F23.x; F24.x; F25.x; F28; F29
Product: MEMANTINE, ARIPIPRAZOLE, Coated tablets to match memantine (10/20mg)

Primary endpoint: Primary Endpoints Primary endpoint will be reduction in negative symptoms as measured with Positive and Negative Syndrome Scale (PANSS) negative symptoms after 12 weeks of treatment [PANSS negative baseline - PANSS negative at week 12]. Assessments will be supplemented by Brief Negative Symptom Scale (BNSS) scores.
Endpoint(s): changes in cognition (in particular working memory, set-shifting, and attention), Change in PANSS positive and PANSS total, clinical measures, level of functioning, side effects, glutamate levels in five a priori selected regions: thalamus, anterior cingulate cortex (ACC), hippocampus, dorsolateral prefrontal cortex (DLPFC), and basal ganglia., Exploratory endpoints include associations between clinical data, quality of life, brain metabolites in other regions, e.g. ACC, and structural measures (e.g. hippocampus subfields), and basal ganglia quantification (See Table 1 for detailed assessments). Interactions between baseline brain metabolite levels and brain structure in patients and HC will also be investigated.

Source: https://euclinicaltrials.eu/ctis-public/view/2024-513878-21-02